EU clinical trial 2024-512827-36-00: MEGACEP_Prospective Phase II Study Evaluating a Multimodal Care of Inguinal Node Metastasis in Squamous Cell Carcinoma of the Penis by Bilateral Lymphadenectomy and Chemotherapy TIP
Protocol code: UC_0160/1406
Sponsor: Unicancer (Hospital/Clinic/Other health care facility). Phase: Therapeutic exploratory (Phase II). Countries: France (ongoing, recruiting).
Therapeutic area(s): Diseases [C] - Neoplasms [C04]
Gender: Male. Age: 18-64 years, 65+ years. Enrolment: 37.
Status: Ongoing, recruiting. Start date (EU): 2016-10-17. Decision date: 2024-05-14. Results received: No. Last updated: 2024-05-14.

Condition(s): Penis carcinoma
Product: IFOSFAMIDE, CISPLATIN, PACLITAXEL, METHYLPREDNISOLONE, RANITIDINE, MESNA, APREPITANT, DEXCHLORPHENIRAMINE MALEATE

Primary endpoint: Survival without locoregional lymph node recurrence [ Time Frame: 24 months ] checked by inguinal ultrasound

Source: https://euclinicaltrials.eu/ctis-public/view/2024-512827-36-00